EU clinical trial 2024-515381-14-00: Phase IV, multicenter, open-label, single-arm, open-label study to evaluate the safety of almagate in pregnant women with acidity and heartburn, and on perinatal outcomes in the fetus and newborn
Protocol code: M-00ALM-04
Sponsor: Almirall S.A. (Pharmaceutical company). Phase: Therapeutic use (Phase IV). Countries: Spain (ongoing, recruitment ended).
Therapeutic area(s): Diseases [C] - Stomatognathic Diseases [C07]; Diseases [C] - Digestive System Diseases [C06]
Gender: Female. Age: 18-64 years. Enrolment: 297.
Status: Ongoing, recruitment ended. Start date (EU): 2024-11-20. Decision date: 2024-10-07. Results received: No. Last updated: 2026-06-29.

Condition(s): heartburn and or reflux
Product: Almax Forte 1,5 g suspensión oral

Primary endpoint: Data collected at baseline and follow-up visits: Gestational diabetes, Data collected at baseline and follow-up visits: Hypertensive states of pregnancy (Gestational hypertension (HT), Pre-eclampsia, Eclamps)ia, Data collected at the delivery visit: Abruptio placentae, Data collected at the delivery visit: Immediate postpartum haemorrhage, Data collected at the delivery visit: Perinatal mortality (Foetal death, Neonatal mortality), Data collected at the delivery visit: Maternal mortality, Data collected at the delivery visit: Low birth weight
Endpoint(s): Type of delivery: Vaginal delivery, Instrumental, Caesarean section, Birthing start: Spontaneous , Induced, Planned Caesarean section, Weight and length of the newborn (NB), Gestational age (GA) of NB at delivery: GA <37 weeks: pre-term NB, GA 37-42 weeks: full-term NB, GA >42 weeks: post-term NB, NB APGAR, Date of delivery: identification of pre-term, full-term, and post-term delivery., Physical examination will include a complete head and neck examination, a cardiovascular, respiratory, abdominal and a complete neurological examination, including state of consciousness, motor system, primitive reflexes, osteotendinous reflexes, muscle tone, and sensitivity, The total score of the ASQ-3™ questionnaire taken at 24 months of age will be assessed, either as the score in each of the five different areas comprising this questionnaire: communication, gross motor, fine motor, problem solving and personal-social., The efficacy of almagate as antacid will be assessed at each follow-up visit referring to each episode of heartburn/reflux by the general impression of the physician, on the one hand, and of the patient, on the other hand, classifying it as "very good", "good", "acceptable", "poor", "very poor" after the question "How would you classify your experience with the use of almagate for the treatment of heartburn/reflux?"., Patient satisfaction will be assessed at the follow-up visits through her response on the degree of agreement with the statement “I am satisfied with the use of almagate as antacid”, with 5 scoring options, from “completely disagree” to “completely agree” (Likert scale).

Source: https://euclinicaltrials.eu/ctis-public/view/2024-515381-14-00